EU clinical trial 2023-504597-37-00: A pivotal Phase 3, multicenter, randomized, double-blind, placebo-controlled study of the efficacy and safety of DMX-200 in patients with focal segmental glomerulosclerosis (FSGS) who are receiving an angiotensin II receptor blocker (ARB)
Protocol code: DMX-200-301
Sponsor: Dimerix Bioscience Pty Limited (Pharmaceutical company). Phase: Therapeutic confirmatory (Phase III). Countries: France (ongoing, recruitment ended), Spain (ongoing, recruitment ended), Denmark (ongoing, recruitment ended), Germany (ongoing, recruitment ended), Italy (ongoing, recruitment ended), Portugal (ongoing, recruitment ended), Czechia (ongoing, recruitment ended).
Therapeutic area(s): Diseases [C] - Immune System Diseases [C20]
Gender: Female, Male. Age: 0-17 years, 18-64 years, 65+ years. Enrolment: 95.
Status: Ongoing, recruitment ended. Start date (EU): 2022-03-25. Decision date: 2023-06-29. Results received: No. Last updated: 2026-01-19.
Decision dates by country: DK: 2023-06-29, ES: 2023-06-29, DE: 2024-04-02, IT: 2024-03-29, FR: 2023-07-04, PT: 2024-02-19, CZ: 2025-03-24

Condition(s): Focal segmental glomerulosclerosis
Product: Placebo capsule, Repagermanium

Primary endpoint: Percent change in urine PCR (based on 24-hour urine collection) following treatment with DMX-200 compared with placebo, Slope of eGFR following treatment with DMX-200 compared with placebo, OLE: Incidence and severity of treatment-related AEs and any AESIs and SAEs following long-term treatment with DMX-200
Endpoint(s): Incidence and severity of AEs following treatment with DMX-200 compared with placebo, Incidence of clinically significant changes in the safety profile of patients treated with DMX-200 compared with placebo, as measured by changes from baseline in clinical laboratory evaluations (hematology, coagulation, clinical chemistry, and urinalysis), ECGs, vital signs, and physical examinations, Proportion of patients achieving proteinuria response following treatment with DMX-200 compared with placebo at any time during the double-blind period, defined as: - Complete response: 24-hour urine PCR reduction to <0.3 g/g [<33.9 mg/mmol] - Modified partial remission (FPRE): 24-hour urine PCR reduction ≥40% from Baseline and <1.5 g/g [<169.5 mg/mmol] - No response (failure to meet any response criteria), Proportion of patients on treatment with DMX-200 compared with placebo that meet a composite endpoint of worsening in kidney function, as defined by the onset of kidney failure (initiation of chronic dialysis, kidney transplantation, or a sustained eGFR of <15 mL/min/1.73 m2), a 40% decline in eGFR from Baseline, or death from kidney or cardiovascular causes, OLE: Slope of eGFR from Week 108 (Baseline), OLE: Percent change in urine PCR (based on first morning void urine samples) from Week 108 (Baseline) at each visit, OLE: Proportion of patients on treatment with DMX 200 that meet a composite endpoint of worsening in kidney function, as defined by the onset of kidney failure (initiation of chronic dialysis, kidney transplantation, or a sustained eGFR of <15 mL/min/1.73 m2), a 40% decline in eGFR from Baseline, or death from kidney or cardiovascular causes, OLE: Change in eGFR from Week 108 (Baseline) at each visit

Source: https://euclinicaltrials.eu/ctis-public/view/2023-504597-37-00